EU clinical trial 2022-501564-18-00: A Phase II, single-blind, randomized, controlled study to evaluate the immunogenicity and safety of a measles, mumps, rubella, varicella vaccine compared with ProQuad, administered in healthy children 4 to 6 years of age
Protocol code: 217715
Sponsor: GlaxoSmithKline Biologicals (Pharmaceutical company). Phase: Therapeutic exploratory (Phase II). Countries: Latvia (ended), Spain (not authorised).
Therapeutic area(s): Diseases [C] - Virus Diseases [C02]
Gender: Female, Male. Age: 0-17 years. Enrolment: 110.
Status: Ended. Start date (EU): 2023-07-31. End date (EU): 2024-10-10. End date: 2024-12-20. Decision date: 2023-04-19. Results received: Yes. Last updated: 2024-05-23.
Decision dates by country: ES: 2023-04-19, LV: 2023-04-21

Condition(s): Healthy volunteers (prevention of measles, mumps, rubella and varicella infections)
Product: ProQuad powder and solvent for suspension for injection in a pre-filled syringe Measles, mumps, rubella and varicella vaccine (live)

Primary endpoint: Anti-measles antibody geometric mean concentrations (GMCs) at Day 43., Anti-mumps antibody geometric mean concentrations (GMCs ) at Day 43., Anti-rubella antibody geometric mean concentrations (GMCs) at Day 43., Anti-glycoprotein E (gE) antibody geometric mean concentrations (GMCs) at Day 43.
Endpoint(s): Percentage of participants with seroresponse to anti-measles antibodies at Day 43., Percentage of participants with seroresponse to anti-mumps antibodies at Day 43., Percentage of participants with seroresponse to anti-rubella antibodies at Day 43., Percentage of participants with seroresponse to varicella anti-gE antibodies at Day 43., Percentage of participants reporting each solicited administration site event during the 4-day (day of administration and 3 following days) period after the administration of study interventions (administered at Day 1)., Percentage of participants reporting each solicited systemic event in terms of drowsiness and loss of appetite during the 4-day (day of administration and 3 following days) period after the administration of study interventions (administered at Day 1), Percentage of participants reporting each solicited systemic event in terms of fever, measles/rubella-like rash, varicella-like rash and other rash (not measles/rubella-like rash or varicella-like rash) during the 43-day period (day of administration and 42 following days) after the administration of study interventions (administered at Day 1)., Percentage of participants reporting unsolicited adverse events (AEs) during the 43-day period (day of administration and 42 following days) after the administration of study interventions (administered at Day 1), Percentage of participants reporting serious adverse events (SAEs) throughout the entire study period (From Day 1 to Day 181).

Source: https://euclinicaltrials.eu/ctis-public/view/2022-501564-18-00